EU clinical trial 2024-512423-36-00: A Multicenter, Randomized, Phase 3 Study to Assess the Efficacy and Safety of INtratumorally Administered INT230-6 (SHAO, VINblastine, CIsplatin) Compared With US Standard of Care in Adult Participants With Locally Recurrent, InoperaBLE, or Metastatic Soft Tissue Sarcomas - (THE INVINCIBLE-3 TRIAL)
Protocol code: IT-03
Sponsor: Intensity Therapeutics Inc. (Pharmaceutical company). Phase: Therapeutic confirmatory (Phase III). Countries: Spain (temporarily halted), France (temporarily halted), Poland (authorised, recruitment pending), Germany (temporarily halted), Italy (authorised, recruitment pending).
Therapeutic area(s): Diseases [C] - Neoplasms [C04]
Gender: Female, Male. Age: 18-64 years, 65+ years. Enrolment: 118.
Start date (EU): 2024-11-20. Decision date: 2024-09-16. Results received: No. Last updated: 2026-06-08.
Decision dates by country: FR: 2024-09-17, DE: 2024-09-16, ES: 2024-09-17, PL: 2024-09-16, IT: 2024-09-16

Condition(s): Leiomyosarcoma (non-uterine), liposarcoma (dedifferentiated, myxoid, round cell or pleomorphic), Undifferentiated pleomorphic sarcoma
Product: Trabectedin EVER Pharma 1 mg Pulver für ein Konzentrat zur Herstellung einer Infusionslösung, HALAVEN 0.44 mg/ml solution for injection, Pazopanib PharOS 200 mg film-coated tablets

Primary endpoint: Overall survival (OS), as defined as the time from date of randomization to date of death due to any cause.
Endpoint(s): OS as defined as the time from date of randomization to date of death due to any cause., Exploratory: The incidence of grade 3 or higher drug-related AEs will be assessed by the incidence of > grade 3 drug-related AEs according to the CTCAE (v6.0)., Exploratory: Change from baseline in the global health status/QoL scale score of the EORTC QLQC30 (Time Frame: Up to 24 months)., Exploratory: Summary of composite measure of change from baseline in the domain scores, health states, overall health status, and index values at the time of each assessment., Exploratory: Time to 10% definitive deterioration in the global health status/QOL scale score of the EORTC QLQ-C30 (Time Frame: Up to 24 months)., Exploratory: Definitive deterioration: time from date of randomization to date of event, defined as at least a 10% worsening from baseline with no later improvement above this threshold observed during the course of the treatment or until death due to any cause, in the global health status/QOL scale score of EORTC QLQ-C30., Exploratory: Changes in safety parameters including laboratory test results, ECOG performance status, etc.

Source: https://euclinicaltrials.eu/ctis-public/view/2024-512423-36-00